EU clinical trial 2023-510384-36-00: Phase 3 Study of Teclistamab in Combination With Lenalidomide and Teclistamab Alone versus Lenalidomide Alone in Participants With Newly Diagnosed Multiple Myeloma as Maintenance Therapy Following Autologous Stem Cell Transplantation – MajesTEC-4
Protocol code: EMN30
Sponsor: European Myeloma Network B.V., Emn Trial Office S.r.l. Impresa Sociale (Patient organisation/association, Laboratory/Research/Testing facility). Phase: Therapeutic confirmatory (Phase III). Countries: Italy (ongoing, recruiting), Czechia (ongoing, recruiting), Denmark (ongoing, recruiting), Netherlands (ongoing, recruiting), Ireland (ongoing, recruiting), Norway (ongoing, recruiting), Greece (ongoing, recruiting), Austria (ongoing, recruiting), Germany (ongoing, recruiting), Belgium (ongoing, recruiting), Poland (ongoing, recruiting), France (ongoing, recruiting), Portugal (ongoing, recruiting).
Therapeutic area(s): Diseases [C] - Neoplasms [C04]
Gender: Female, Male. Age: 18-64 years, 65+ years. Enrolment: 1162.
Status: Ongoing, recruiting. Start date (EU): 2022-09-13. Decision date: 2024-07-02. Results received: No. Last updated: 2026-06-05.
Decision dates by country: DK: 2024-07-02, AT: 2024-07-08, IE: 2024-07-02, GR: 2024-09-09, NO: 2024-07-02, FR: 2024-07-05, DE: 2024-07-05, PT: 2025-04-10, BE: 2024-07-02, CZ: 2024-07-04, IT: 2024-07-08, NL: 2024-07-03, PL: 2024-07-05

Condition(s): Newly Diagnosed Multiple Myeloma
Product: Lenalidomide Accord 10 mg hard capsules, teclistamab, Lenalidomide Accord 5 mg hard capsules, teclistamab, Lenalidomide Accord 15 mg hard capsules, Lenalidomide Accord 2.5 mg hard capsules

Primary endpoint: PFS (per IRC) and 12-month MRD-negative CR (per IRC) are the dual primary endpoints for the study.
Endpoint(s): OS is defined as the time from the date of randomization to the date of the participant’s death due to any cause., CR or better (sCR+CR) is defined as participants who achieve a CR or better response per IMWG criteria., CR conversion is defined as participants who were not in CR or better at the time of randomization but later went on to achieve CR or better prior to progressive disease or subsequent therapy, whichever is earlier., MRD-negative CR is defined as participants who achieve CR or better and MRD-negative status, as determined by NGF with sensitivity of 10-5, prior to progressive disease or subsequent therapy, whichever is earlier., MRD-negative conversion is defined as participants who have not achieved MRD-negative status at the time of randomization and who later achieved MRD-negative, prior to progressive disease or subsequent therapy, whichever is earlier., Sustained MRD-negative CR is defined as participants who achieve MRD-negative CR, confirmed minimum 1 year apart and without any examination showing MRD-positive status in between., PFS2 is defined as the time interval between the date of randomization and date of event, which is defined as progressive disease as assessed by investigator on the first subsequent line of antimyeloma therapy, or death from any cause, whichever occurs first. Those who are alive and for whom a second disease progression has not been observed will be censored at the last date of follow-up., TTNT is defined as the time from randomization to the start of subsequent antimyeloma treatment. Death due to progressive disease without start of subsequent therapy will be considered as event. Participants who withdrew full consent to study or are lost to follow-up, or die due to causes other than disease progression will be censored at the date of death or the last date known to be alive., Incidence and severity of AEs, The PK of teclistamab., Presence and activity of ADAs to teclistamab, Time to worsening in overall HRQoL, symptoms, and functioning Change from baseline in overall HRQoL, symptoms, and functioning

Source: https://euclinicaltrials.eu/ctis-public/view/2023-510384-36-00